EU clinical trial 2023-505722-33-00: TRAP-BTC Efficacy and safety of GemCis plus Trastuzumab plus Pembrolizumab in previously untreated HER2-positive biliary tract cancer
Protocol code: TRAP-BTC
Sponsor: Institut fuer Klinische Krebsforschung IKF GmbH (Pharmaceutical company). Phase: Therapeutic exploratory (Phase II). Countries: Germany (ongoing, recruitment ended).
Therapeutic area(s): Diseases [C] - Neoplasms [C04]
Gender: Female, Male. Age: 18-64 years, 65+ years. Enrolment: 24.
Status: Ongoing, recruitment ended. Start date (EU): 2024-04-15. Decision date: 2023-12-11. Results received: No. Last updated: 2026-04-13.

Condition(s): cholangiocarcinoma or gallbladder carcinoma
Product: Zercepac 150 mg powder for concentrate for solution for infusion., KEYTRUDA 25 mg/mL concentrate for solution for infusion, Gemcitabin-GRY 1000 mg Pulver zur Herstellung einer Infusionslösung, Cisplatin Teva® 1 mg/ml Konzentrat zur Herstellung einer Infusionslösung

Primary endpoint: ORR@6, defined as proportion of subjects with complete response (CR) or partial response (RP) according to unconfirmed RECIST v1.1 at 6 months after treatment initiation.
Endpoint(s): PFS, defined as time from enrolment until the date of first objectively documented progression according to RECIST v1.1, OS, defined as time from enrolment to the date of death of any cause, PFS rate at 6, 9 and 12 months (PFSR@6, PFSR@9, PFSR@12), defined as proportion of patients without progression after 6, 9 and 12 months, Assessment of safety of the treatment as determined by the incidence, nature, causality, seriousness, and severity of adverse events using NCI CTCAE 5.0

Source: https://euclinicaltrials.eu/ctis-public/view/2023-505722-33-00